EU clinical trial 2023-507751-30-00: A Phase 1b/2 Dose-Escalation and Cohort-Expansion Study to Determine the Safety and Efficacy of BGB-11417 as Monotherapy, in Combination With Dexamethasone, Dexamethasone/Carfilzomib, Dexamethasone/Daratumumab, and Dexamethasone/Pomalidomide in Patients With Relapsed/Refractory Multiple Myeloma and t(11;14)
Protocol code: BGB-11417-105
Sponsor: BeOne Medicines AG (Pharmaceutical company). Phase: Phase I and Phase II (Integrated)- Other. Countries: France (ongoing, recruiting), Germany (ongoing, recruiting), Italy (ongoing, recruiting), Greece (ongoing, recruiting), Spain (authorised, recruiting).
Therapeutic area(s): Diseases [C] - Neoplasms [C04]
Gender: Female, Male. Age: 18-64 years, 65+ years. Enrolment: 70.
Start date (EU): 2024-05-27. Decision date: 2024-04-10. Results received: No. Last updated: 2026-06-26.
Decision dates by country: DE: 2024-04-12, ES: 2024-05-30, GR: 2024-04-12, IT: 2024-04-12, FR: 2024-04-15

Condition(s): relapsed or refractory multiple myeloma
Product: DARZALEX 1800 mg solution for injection, Kyprolis 60 mg powder for solution for infusion, BGB-11417, Imnovid 1 mg hard capsules, DEXAMETHASONE

Primary endpoint: Part 1 (Dose Escalation): Safety and tolerability of sonrotoclax in combination with dexamethasone, dexamethasone plus carfilzomib, dexamethasone plus daratumumab, and dexamethasone plus pomalidomide as assessed by (a) Protocol-defined dose limiting toxicities (DLTs), and (b) The incidence, timing, and severity of treatment-emergent adverse events (TEAEs), serious adverse events, adverse events leading to discontinuation, and adverse events of special interest (AESIs) per NCI CTCAE v5.0, Part 2 (Cohort Expansion): Safety and tolerability of sonrotoclax at the recommended Phase 2 dose (RP2D) as monotherapy, in combination with dexamethasone, and in combination with dexamethasone plus carfilzomib at the recommended dose combination(s), as assessed based on the incidence, timing, and severity of DLTs (for sonrotoclax monotherapy only), TEAEs, serious adverse events, adverse events leading to discontinuation, and AESIs according to NCI-CTCAE v5.0, Part 2 (Cohort Expansion): Overall response rate (ORR), defined as the proportion of patients who achieved a stringent complete response (sCR), complete response (CR), very good partial response (VGPR), or partial response (PR) per International Myeloma Working Group (IMWG) guidelines, Part 2 (Cohort Expansion): VGPR or better response rate, defined as the proportion of patients with a documented VGPR or better (including sCR, CR, and VGPR), Part 2 (Cohort Expansion): CR or sCR rate, defined as the proportion of patients with a documented CR or sCR.
Endpoint(s): Part 1 (Dose Escalation): Derived PK parameters of sonrotoclax, including: (a) For a single dose: area under the plasma concentration-time curve from time 0 to the last measurable concentration (AUClast), maximum observed plasma concentration (Cmax), and time to reach Cmax (tmax) as appropriate. (b) After steady-state (ss): AUClast,ss, Cmax,ss, trough plasma concentration (Ctrough) ss, and tmax,ss. Other PK parameters may be reported., Part 2 (Cohort Expansion): Time to response (TTR) as assessed by investigator, defined as the time from start of treatment (for nonrandomized cohorts) or date of randomization (for randomized cohorts [Part 2 Cohorts 3, 4, and 5]) to first documentation of response of PR or better., Part 2 (Cohort Expansion): Duration of response (DOR) is defined as the time from the date of the first documented response (PR or better) after treatment initiation until the date of first documented disease progression or death due to any cause, whichever occurs first., Part 2 (Cohort Expansion): Progression-free survival (PFS) as assessed by investigator, defined as time from start of treatment (for nonrandomized cohorts) or date of randomization (for randomized cohorts [Part 2 Cohorts 3, 4, and 5]) to the first documentation of disease progression or death, whichever occurs first., Part 2 (Cohort Expansion): Overall survival (OS), defined as the time from start of treatment (for nonrandomized cohorts) or date of randomization (for randomized cohorts [Part 2 Cohorts 3, 4, and 5]) to the date of death due to any cause.

Source: https://euclinicaltrials.eu/ctis-public/view/2023-507751-30-00